EU clinical trial 2024-515169-33-00: Blomia tropicalis allergen extract. Determination of the vivo histamine equivalent prick test units
Protocol code: M608-STD-067
Sponsor: Inmunotek S.L. (Pharmaceutical company). Phase: Therapeutic exploratory (Phase II). Countries: Spain (ended).
Therapeutic area(s): Diseases [C] - Immune System Diseases [C20]
Gender: Female, Male. Age: 18-64 years. Enrolment: 30.
Status: Ended. Start date (EU): 2025-11-25. End date (EU): 2026-05-20. Decision date: 2025-10-20. Results received: Yes. Last updated: 2025-10-20.

Condition(s): Allergy to Blomia tropicalis
Product: Skin Prick Test Negative control, Prick test of Blomia tropicalis extract, Skin Prick Test Positive control

Primary endpoint: The primary efficacy endpoint involves measuring the area (mm2) of the induced wheal on the skin upon applying each of the 3 concentrations of the allergenic extract, as well as those induced by positive (histamine) and negative controls, through the prick test.
Endpoint(s): Overall rate, seriousness, and ratio of any adverse event (AE) by administration and by subject., Assessment of administration site reactions, systemic reactions and any medication administered for the treatment of adverse reaction (AR).

Source: https://euclinicaltrials.eu/ctis-public/view/2024-515169-33-00